EU clinical trial 2022-502902-33-00: Safety and efficacy of olanzapine treatment in psychosis: Effect of genetic and epigenetic factors – covariates of treatment response
Protocol code: SEOTP-2022
Sponsor: Masarykova Univerzita (Educational Institution). Phase: Therapeutic use (Phase IV). Countries: Czechia (ended).
Therapeutic area(s): Psychiatry and Psychology [F] - Behavioral Disciplines and Activities [F04]
Gender: Female, Male. Age: 18-64 years. Enrolment: 200.
Status: Ended. Start date (EU): 2023-10-24. End date (EU): 2025-09-23. Decision date: 2023-05-04. Results received: No. Last updated: 2025-05-16.

Condition(s): Psychoses
Product: OLANZAPINE

Primary endpoint: Frequency of gene polymorphisms of CYP1A2, MDR1, 5HT2A, 5HT2C, HDAC3 and HDAC4
Endpoint(s): Cytosine methylation of 5HT2A, Metabolic phenotype of CYP1A2, Response rate: The treatment response is defined as 20% reduction in PANSS score (see Chapter 7.2) on day 14 or 30% reduction in PANSS score on day 28 compared to baseline score., Remission rate: Remission is defined in compliance with the “Remission in Schizophrenia Working Group” as reduction of the severity of symptoms evaluated in items P1, P2, P3, G5, G9, N1, N4, N6 of PANSS scale to ≤ 3 degree; with respect to the study period, although the original recommended time factor (6 months) will not be included in the evaluation., Time to reach the treatment response (i.e., 20% reduction in PANSS score)., Number of "drop-outs" (olanzapine treatment cessation) and their reasons., Side effects assessment: UKU scale (see Chapter 8.3), Treatment of the adverse effects of olanzapine – medication, doses, treatment duration, changes in olanzapine administration.

Source: https://euclinicaltrials.eu/ctis-public/view/2022-502902-33-00